EU clinical trial 2024-518003-22-00: A Single Group Treatment, Phase 2 study to investigate Pharmacokinetics, Safety and Tolerability of Cefepime-Enmetazobactam administered by intra-venous infusion over 2 hours in Male or Female Participants from birth to less than 18 years of age hospitalized with complicated urinary tract infections (cUTI) including Acute Pyelonephritis (AP).
Protocol code: AT-202
Sponsor: Orchid Pharma Europe GmbH (Pharmaceutical company). Phase: Therapeutic exploratory (Phase II). Countries: Czechia (ended), Hungary (ongoing, recruitment ended), Spain (ended), Poland (ongoing, recruitment ended), Slovakia (ongoing, recruitment ended), France (temporarily halted).
Therapeutic area(s): Diseases [C] - Bacterial Infections and Mycoses [C01]
Gender: Female, Male. Age: 0-17 years. Enrolment: 30.
Start date (EU): 2023-01-20. Decision date: 2024-12-11. Results received: No. Last updated: 2026-06-19.
Decision dates by country: CZ: 2024-12-11, FR: 2024-12-11, ES: 2024-12-11, HU: 2024-12-14, PL: 2024-12-16, SK: 2024-12-11

Condition(s): Complicated urinary tract infections including acute pyelonephritis
Product: EXBLIFEP 2 g/0.5 g powder for concentrate for solution for infusion

Primary endpoint: Cmax, Tmax, AUClast, AUC0-tau (repeat dose) , AUC0-inf , AUCextr, half-life, λz, CL, Vd, Cmin, CLss (repeat dose), Vss (repeat dose), Accumulation ratio (repeat dose), Treatment emergent adverse events including monitoring of adverse events of special interests: o Any increase in ALT or AST >3 times the age-specific upper limit of normal or total bilirubin >2 times ULN. o Clostridium difficile-associated diarrhoea CDAD)/Pseudomembranous colitis o Hypersensitivity reactions, anaphylactic reactions, angioedema o Encephalopathy/ seizures / convulsions//delirium, Laboratory parameters, ECGs, vital signs, and physical examination
Endpoint(s): Overall success rate (Combined clinical and microbiological success rate), Clinical response, Microbiological response

Source: https://euclinicaltrials.eu/ctis-public/view/2024-518003-22-00